EU clinical trial 2024-515797-27-00: Phase 2, Multicentre, Randomised, Double-blind, Placebo-controlled Safety and Efficacy Study of CDR132L on Reverse Cardiac Remodelling in Participants with Heart Failure with Reduced/Mildly Reduced Ejection Fraction and Left Ventricular Hypertrophy.
Protocol code: NN6706-8282
Sponsor: Novo Nordisk A/S (Pharmaceutical company). Phase: Therapeutic exploratory (Phase II). Countries: Poland (ongoing, recruiting), Czechia (ongoing, recruiting), Spain (ongoing, recruiting), Netherlands (ongoing, recruiting), Germany (ongoing, recruiting).
Therapeutic area(s): Diseases [C] - Cardiovascular Diseases [C14]
Gender: Female, Male. Age: 18-64 years, 65+ years. Enrolment: 113.
Status: Ongoing, recruiting. Start date (EU): 2025-06-25. Decision date: 2025-05-26. Results received: No. Last updated: 2026-05-28.
Decision dates by country: DE: 2025-05-26, ES: 2025-05-28, PL: 2025-05-28, CZ: 2025-05-27, NL: 2025-06-20

Condition(s): Heart Failure with Reduced/Mildly Reducede Ejection Fraction and Left Ventricular Hypertrophy.

Primary endpoint: Change in normalised miR-132 from baseline (V2) to week 24 (V14). Unit: Ratio to baseline
Endpoint(s): Change in composite Z score based on the 3 outcome measures LVEDVi, LVESVi and NT-proBNP from baseline (V2) to week 24 (V14). Unit: Score, Number of adverse events from baseline (V2) to week 24 (V14). Unit: Count, Number of adverse events from baseline (V2) to week 60 (V27). Unit: Count

Source: https://euclinicaltrials.eu/ctis-public/view/2024-515797-27-00